EU clinical trial 2023-505340-19-00: A Drug Absorption Study of MK-3475A in Participants with Solid Tumors
Protocol code: MK-3475A-C18
Sponsor: Merck Sharp & Dohme LLC (Pharmaceutical company). Phase: Human Pharmacology (Phase I)- Other. Countries: Spain (ended), Hungary (ended).
Therapeutic area(s): Diseases [C] - Neoplasms [C04]
Gender: Female, Male. Age: 18-64 years, 65+ years. Enrolment: 34.
Status: Ended. Start date (EU): 2021-09-20. End date (EU): 2024-09-19. End date: 2026-05-19. Decision date: 2023-10-11. Results received: No. Last updated: 2024-02-20.
Decision dates by country: HU: 2023-10-11, ES: 2023-10-11

Condition(s): Advanced or Metastatic Solid Tumors

Source: https://euclinicaltrials.eu/ctis-public/view/2023-505340-19-00